EU clinical trial 2023-510319-20-00: A Randomized, Multicenter, Phase 3 Study of Zanidatamab in Combination with Chemotherapy with or without Tislelizumab in Subjects with HER2-positive Unresectable Locally Advanced or Metastatic Gastroesophageal Adenocarcinoma (GEA)
Protocol code: ZWI-ZW25-301
Sponsor: Jazz Pharmaceuticals Ireland Limited (Pharmaceutical company). Phase: Therapeutic confirmatory (Phase III). Countries: Romania (ongoing, recruitment ended), Ireland (ongoing, recruitment ended), Germany (ongoing, recruitment ended), Greece (ongoing, recruitment ended), Netherlands (ongoing, recruitment ended), Estonia (ongoing, recruitment ended), France (ongoing, recruitment ended), Portugal (ongoing, recruitment ended), Poland (ongoing, recruitment ended), Spain (ongoing, recruitment ended), Italy (ongoing, recruitment ended), Belgium (ongoing, recruitment ended).
Therapeutic area(s): Diseases [C] - Digestive System Diseases [C06]
Gender: Female, Male. Age: 18-64 years, 65+ years. Enrolment: 251.
Status: Ongoing, recruitment ended. Start date (EU): 2021-10-21. Decision date: 2024-10-07. Results received: No. Last updated: 2026-08-03.
Decision dates by country: PL: 2024-11-13, IE: 2024-10-07, RO: 2024-10-11, DE: 2024-10-11, EE: 2024-10-14, NL: 2024-10-08, BE: 2024-10-07, GR: 2024-10-11, PT: 2024-10-07, ES: 2024-10-08, IT: 2024-11-11, FR: 2024-10-11

Condition(s): Gastroesophageal Adenocarcinoma (GEA)
Product: CAPECITABINE, JZP598, LOPERAMIDE, Tislelizumab, TRASTUZUMAB, Oxaliplatin 5 mg/ml concentrate for solution for infusion

Primary endpoint: ●Progression-free survival (PFS) by the Response Evaluation Criteria in Solid Tumors version 1.1 (RECIST 1.1), assessed by blinded independent central review (BICR), ●Overall survival (OS) The primary PFS analysis will be performed once the target event count has been reached for each comparison. This is estimated to occur 7 months after the last subject is randomized. At this time, interim analyses of OS will be performed.
Endpoint(s): ●Confirmed objective response rate (ORR) by RECIST 1.1, assessed by BICR, ●Duration of response (DOR) by RECIST 1.1, assessed by BICR, ●PFS by RECIST 1.1, per investigator assessment, ●Change from baseline in health economics and outcomes research / patient-reported outcomes (HEOR/PRO) parameters, ●Serum concentration and PK parameters for zanidatamab, ●Serum concentrations for tislelizumab

Source: https://euclinicaltrials.eu/ctis-public/view/2023-510319-20-00